EU clinical trial 2023-508759-38-00: A Study to Learn More About an Investigational Medicine called HDP-102 in Patients with Relapsed/Refractory B-cell Blood Cancers.
Protocol code: HDP-102-01
Sponsor: Heidelberg Pharma AG (Pharmaceutical company). Phase: Human Pharmacology (Phase I)- First administration to humans. Countries: Romania (ended), Poland (ended), Spain (ended).
Therapeutic area(s): Diseases [C] - Hemic and Lymphatic Diseases [C15]
Gender: Female, Male. Age: 18-64 years, 65+ years. Enrolment: 28.
Status: Ended. Start date (EU): 2025-06-04. End date (EU): 2026-04-02. End date: 2026-06-25. Decision date: 2025-03-12. Results received: No. Last updated: 2025-08-18.
Decision dates by country: PL: 2025-03-24, RO: 2025-03-24, ES: 2025-03-12

Condition(s): Relapsed/Refractory B-cell Malignancies

Source: https://euclinicaltrials.eu/ctis-public/view/2023-508759-38-00